EU clinical trial 2023-504952-87-00: Impact of Doravirine in Liver Steatosis and Fibrosis in PLWH. A pilot, proof of concept study (DORALI Study)
Protocol code: DORALI
Sponsor: Fundacion Fls De Lucha Contra El Sida Las Enfermedades Infecciosas Y La Promocion De La Salud Y La Ciencia (Patient organisation/association). Phase: Therapeutic use (Phase IV). Countries: Spain (ongoing, recruitment ended).
Therapeutic area(s): Diseases [C] - Virus Diseases [C02]; Diseases [C] - Immune System Diseases [C20]
Gender: Female, Male. Age: 18-64 years, 65+ years. Enrolment: 50.
Status: Ongoing, recruitment ended. Start date (EU): 2025-01-13. Decision date: 2024-03-11. Results received: No. Last updated: 2024-09-18.

Condition(s): Human Immunodeficiency Virus
Product: Biktarvy 50 mg/200 mg/25 mg film-coated tablets, Descovy 200 mg/25 mg film-coated tablets, Delstrigo 100 mg/300 mg/245 mg film-coated tablets, Pifeltro 100 mg film-coated tablets

Primary endpoint: Liver steatosis measured and liver fibrosis measured by CAP (Controlled Attenuation-Parameter, expressed in db/m) and transient elastography respectively
Endpoint(s): Fat liver content by MRI, Lipoprotein particles at week 48

Source: https://euclinicaltrials.eu/ctis-public/view/2023-504952-87-00